EU clinical trial 2023-504367-16-00: A Phase 1b/2a, Multicenter, Open-Label Study to Determine the Recommended Dose and Schedule, and Evaluate the Safety and Preliminary Efficacy of Alnuctamab in Combination with Mezigdomide in Participants with Relapsed and/or Refractory Multiple Myeloma
Protocol code: CA058-002
Sponsor: Celgene International II S.a.r.l. (Pharmaceutical company). Phase: Therapeutic exploratory (Phase II). Countries: Denmark (not authorised).
Therapeutic area(s): Diseases [C] - Neoplasms [C04]
Gender: Female, Male. Age: 18-64 years, 65+ years. Enrolment: 14.
Status: Not authorised. Decision date: 2024-01-11. Results received: No. Last updated: 2024-01-11.

Condition(s): Relapsed and/or Refractory Multiple Myeloma
Product: Alnuctamab, Alnuctamab, CC-92480 0.3 mg, CC-92480 0.4 mg, CC-92480 0.6 mg, DEXAMETHASONE, CC-92480 0.2 mg

Primary endpoint: All phases: Type, frequency, seriousness, and severity of all aAEs;. To be assessed continuously for all participants until 80 days after the last dose of alnuctamab or 28 days after the last dose of mezigdomide, whichever is later., Phase 1b: Establish RP2D and dosing schedule of mezigdomide in combination with alnuctamab for Phase 2a expansion. To be assessed at end of Phase 1., Phase 2a: Overall response rate. To be assessed every cycle for all participants starting at Cycle 2 Day 1 until end of treatment. Participants in efficacy follow-up may be assessed every 8 weeks until dprogression, withdrawal of consent, death, or initiation of new systemic anticancer therapies.
Endpoint(s): All phases: Other myeloma response measures such as very good partial or better rate and complete response rate; time-to-response (the time it takes for a myeloma response after treatment) and duration of response. These will be assessed for all participants starting at Cycle 2 Day 1. Other measures include progression-free survival (the amount of time after starting treatment that the cancer does not worsen) and overall survival, both of which will be assessed continuously, Phase 1b: overall response rate. To be assessed every cycle for all participants starting at Cycle 2 Day 1 until end of treatment. Participants in efficacy follow-up may be assessed every 8 weeks until dprogression, withdrawal of consent, death, or initiation of new systemic anticancer therapies.

Source: https://euclinicaltrials.eu/ctis-public/view/2023-504367-16-00